EU clinical trial 2022-501304-10-00: Bicarbonate for In-Hospital Cardiac Arrest – A Randomized, Double-Blind, Placebo-Controlled Trial
Sponsor: Aarhus University Hospital (Hospital/Clinic/Other health care facility). Phase: Therapeutic use (Phase IV). Countries: Denmark (ongoing, recruitment ended).
Therapeutic area(s): Diseases [C] - Cardiovascular Diseases [C14]
Gender: Female, Male. Age: 18-64 years, 65+ years. Enrolment: 778.
Status: Ongoing, recruitment ended. Start date (EU): 2023-02-06. Decision date: 2022-09-26. Results received: No. Last updated: 2024-10-02.

Condition(s): In-hospital cardiac arrest
Product: Natriumbikarbonat ”SAD”, koncentrat til infusionsvæske, opløsning, Natriumklorid isotonisk "SAD", injektionsvæske, opløsning

Primary endpoint: Return of spontaneous circulation
Endpoint(s): Survival at 30 days, Survival at 30 days with a favorable neurological outcome (modified Rankin Scale score 0 - 3)

Source: https://euclinicaltrials.eu/ctis-public/view/2022-501304-10-00